EU clinical trial 2024-517393-13-00: A Phase 2a, Open-label, Single-arm Study to Evaluate the Efficacy, Safety, and Pharmacokinetics of VX-407 in Subjects with Autosomal Dominant Polycystic Kidney Disease Who Have a Subset of PKD1 Gene Variants
Protocol code: VX24-407-101
Sponsor: Vertex Pharmaceuticals Inc. (Pharmaceutical company). Phase: Therapeutic exploratory (Phase II). Countries: France (ongoing, recruitment ended), Germany (ongoing, recruitment ended), Italy (authorised, recruitment pending), Belgium (ongoing, recruitment ended), Spain (ongoing, recruitment ended), Netherlands (ongoing, recruitment ended).
Therapeutic area(s): Phenomena and Processes [G] - Genetic Phenomena [G05]
Gender: Female, Male. Age: 18-64 years. Enrolment: 10.
Start date (EU): 2025-12-02. Decision date: 2025-11-28. Results received: No. Last updated: 2026-07-08.
Decision dates by country: IT: 2025-12-01, ES: 2025-12-03, BE: 2025-12-02, FR: 2025-11-28, NL: 2025-12-01, DE: 2025-12-01

Condition(s): Autosomal Dominant Polycystic Kidney Disease (ADPKD)
Product: VX-407 tablet

Primary endpoint: Proportion of subjects with percent change from baseline in htTKV ≤0 on MRI over time
Endpoint(s): Percent change from baseline in htTKV on MRI over time, Safety and tolerability of VX¬407 based on adverse events (AEs), clinical laboratory values (i.e., hematology, serum chemistry, coagulation), standard 12-lead ECGs, and vital signs, Plasma PK parameters of VX 407

Source: https://euclinicaltrials.eu/ctis-public/view/2024-517393-13-00